EU clinical trial 2025-524481-15-00: A Phase IIb, Non-Profit, Open-label Trial for the Intrathecal Administration of AAV9/AP4M1 for Hereditary Spastic Paraplegia Type 50 (SPG50).
Protocol code: AAV9/AP4M1-DK01
Sponsor: Rigshospitalet, Elpida Therapeutics SPC (Hospital/Clinic/Other health care facility, Pharmaceutical company). Phase: Therapeutic exploratory (Phase II). Countries: Denmark (authorised, recruitment pending).
Therapeutic area(s): Diseases [C] - Nervous System Diseases [C10]
Gender: Female, Male. Age: 0-17 years. Enrolment: 2.
Status: Authorised, recruitment pending. Decision date: 2026-06-23. Results received: No. Last updated: 2026-06-23.

Condition(s): Heriditary spastic paraplegia (SPG50)
Product: Melpida

Primary endpoint: • Change in total percent score of the eight Major Motor Mile-stones derived from the Gross Motor Function Measure (GMFM)-88 from baseline at W156.

Source: https://euclinicaltrials.eu/ctis-public/view/2025-524481-15-00